EU clinical trial 2024-514892-16-00: Controlled clinical trial to investigate the efficacy and safety of MYRRHINIL-INTEST® versus placebo in patients with diarrhoea-dominant irritable bowel syndrome (IBS-D) and patients with mixed-type irritable bowel syndrome (IBS-M)
Protocol code: Repha_1436
Sponsor: REPHA GmbH Biologische Arzneimittel (Pharmaceutical company). Phase: Therapeutic use (Phase IV). Countries: Germany (ongoing, recruiting).
Therapeutic area(s): Diseases [C] - Digestive System Diseases [C06]
Gender: Female, Male. Age: 18-64 years, 65+ years. Enrolment: 268.
Status: Ongoing, recruiting. Start date (EU): 2020-05-05. Decision date: 2024-10-02. Results received: No. Last updated: 2026-05-19.

Condition(s): Diarrhoea predominant irritable bowel syndrome
Product: MYRRHINIL-INTEST® Überzogene Tabletten 100 mg Myrrhe, 50 mg Kaffeekohle, 70 mg Kamillenblüten-Trockenextrakt, Placebo from the same manufacturer, equals the test product but does not contain active pharmaceutical ingredient

Primary endpoint: Efficacy is assessed by a responder criterion, which is specified differently for patients with IBS-D and IBS-M. For both subgroups, a response of the abdominal pain is required (NRS pain): IBS-D patients: additional assessment of stool consistency stool consistency (Bristol Stool Form Scale). IBS-M patients: additionally an overall assessment of the change in bowel health using the PGI-I scale is also required.
Endpoint(s): Abdominal pain (NRS pain, measured using an 11-point numerical rating scale, pain intensity 0 – 10), daily entry in the patient diary, assessed during visits 1-5 at the study center, Number of spontaneous bowel movements, daily entries by the patient in the patient diary, Stool consistency on individual days measured using the Bristol Stool Form Scale, daily entry in the patient diary, assessed during visits 1-5 at the study center, Frequency of the feeling of incomplete bowel evacuation, daily entries by the patient in the patient diary, Occurrence of mucus and/or blood in the stool on individual days, daily entry in the patient diary, assessed during visits 1-5 at the study center, Assessment of the severity of IBS-D or IBS-M symptoms using the IBS-Severity Scoring System (IBS-SSS) during visits 1-5 (visit assessment: completed by the patient), Determination of quality of life (Quality of Life) using the IBS-QoL questionnaire during visits 1-5 (visit assessment: completed by the patient), Overall assessment of changes in gut health using a 7-point scale (Patient Global Impression of Improvement Scale – PGI-I), assessed at visit 4 at the study center, Global assessment of efficacy by the investigator and the patient during visits 3 and 4 (4-point scale), Reduced use of loperamide, Buscopan®, and mebeverine as emergency medication for the treatment of IBS-D or IBS-M symptoms (visits 1 to 5), Compliance (amount of study medication consumed) during on-site visits 3 and 4 via drug accountability, Adverse events (AEs) throughout the study (V2-V5), Vital signs (blood pressure, pulse, body temperature) at V1-V5, Clinical chemistry and hematology at V1, V3, and V4, Assessment of tolerability by the investigator and the patient during visits 3 and 4

Source: https://euclinicaltrials.eu/ctis-public/view/2024-514892-16-00